EU clinical trial 2024-513509-30-00: EORTC-1407-GUCG: A randomized phase III trial comparing conventional-dose chemotherapy using paclitaxel, ifosfamide, and cisplatin (TIP) with high-dose chemotherapy using mobilizing paclitaxel plus ifosfamide followed by high-dose carboplatin and etoposide (TI-CE) as first salvage treatment in relapsed or refractory germ cell tumors (TIGER)
Protocol code: 1407-GUCG
Sponsor: Europese Organisatie Voor Onderzoek En Behandeling Van Kanker Organisation Europeenne Pour La Recherche Et Le Traitement Du Cancer European Organi (Patient organisation/association). Phase: Therapeutic confirmatory (Phase III). Countries: Germany (ongoing, recruitment ended), Netherlands (ongoing, recruitment ended), France (ongoing, recruitment ended), Ireland (ongoing, recruitment ended), Belgium (ongoing, recruitment ended), Spain (ongoing, recruitment ended), Italy (ongoing, recruitment ended), Denmark (ongoing, recruitment ended).
Therapeutic area(s): Diseases [C] - Neoplasms [C04]
Gender: Male. Age: 0-17 years, 18-64 years, 65+ years. Enrolment: 201.
Status: Ongoing, recruitment ended. Start date (EU): 2016-01-11. Decision date: 2024-08-27. Results received: No. Last updated: 2025-11-24.
Decision dates by country: NL: 2024-08-27, BE: 2024-08-28, DK: 2024-08-30, FR: 2024-09-03, DE: 2024-08-27, IE: 2024-08-27, ES: 2024-09-09, IT: 2024-09-04

Condition(s): Progressive or recurrent germ cell tumor (measurable or non-measurable)
Product: ETOPOSIDE, PACLITAXEL, IFOSFAMIDE, CISPLATIN, CARBOPLATIN

Primary endpoint: Overall survival (OS)
Endpoint(s): Progression Free Survival (PFS), Favorable Response Rate (FRR), Treatment-related mortality, Toxicity

Source: https://euclinicaltrials.eu/ctis-public/view/2024-513509-30-00